EU clinical trial 2024-515793-27-01: MODULO trial: doravirine/lamivudine (DOR/3TC) as a maintenance ART in comparison with dolutegravir/lamivudine (DTG/3TC) in PLWH successfully treated with three-drug regimens at inclusion
Protocol code: CREPATS 19
Sponsor: Centre De Recherches Et D'Etudes Sur La Pathologie Tropicale Et Le Sida, ANRS Maladies Infectieuses Emergentes (Hospital/Clinic/Other health care facility, Laboratory/Research/Testing facility). Phase: Therapeutic confirmatory (Phase III). Countries: France (ongoing, recruiting).
Therapeutic area(s): Diseases [C] - Virus Diseases [C02]
Gender: Female, Male. Age: 18-64 years, 65+ years. Enrolment: 408.
Status: Ongoing, recruiting. Start date (EU): 2025-04-30. Decision date: 2025-01-07. Results received: No. Last updated: 2026-07-16.

Condition(s): HIV
Product: LAMIVUDINE, DORAVIRINE, LAMIVUDINE AND DOLUTEGRAVIR

Primary endpoint: Proportion of participants with virological failure at W48 (2 consecutive pVL >50 copies/mL with a delay of 2-4 weeks).
Endpoint(s): Proportion of participants with virological failure at W96;, Proportion of participants with discontinuation of treatment or follow-up over 96 weeks;, Proportion of participants with new resistance associated mutations in case of virological failure;, Plasma drug concentrations at W24, W48, W72 and W96, and in case of virological failure;, Proportion of participants with severe biological or clinical side effect over 96 weeks;, CD4 and CD8 T-cell counts, CD4/CD8 ratio at D0, W48 and W96;, Body weight and BMI et IMC at D0, W48 and W96;, Metabolic biomarkers (total cholesterol, LDL-cholesterol, HDL-cholesterol, triglycerides and glycemia) at D0, W48 and W96;, Levels of total HIV-DNA in PBMC at D0, W48 and W96;, Proportion of participants with residual viremia at D0, W48 and W96;, Levels of satisfaction associated with study treatments at D0, W48 and W96 (HIVTSQ questionnaire);, Drug concentrations in female genital secretion or semen at W24 and W48 (among participants of the “genital compartment” sub-study);, Levels of HIV-RNA in female genital secretion or semen at W24 and W48 (among participants of the “genital compartment” sub-study).

Source: https://euclinicaltrials.eu/ctis-public/view/2024-515793-27-01